EU clinical trial 2023-508148-23-01: Antiplatelet therapy after successful percutaneous coronary intervention for chronically occluded coronary artery: A prospective, multicentre, randomized study comparing two durations of dual antiplatelet therapy
Protocol code: Etude DAPT-CTO
Sponsor: Assistance Publique Hopitaux De Marseille (Hospital/Clinic/Other health care facility). Phase: Therapeutic confirmatory (Phase III). Countries: France (ongoing, recruiting).
Therapeutic area(s): Diseases [C] - Cardiovascular Diseases [C14]
Gender: Female, Male. Age: 18-64 years, 65+ years. Enrolment: 660.
Status: Ongoing, recruiting. Start date (EU): 2024-12-02. Decision date: 2024-05-16. Results received: No. Last updated: 2025-04-15.

Condition(s): chronically occluded coronary artery
Product: KARDEGIC 75 mg, poudre pour solution buvable en sachet-dose, CLOPIDOGREL, CLOPIDOGREL

Primary endpoint: Net adverse clinical events: time-to-composite endpoint of bleeding events (BARC2 to BARC 5) and/or ischemic events (all cause death, stroke, stent thrombosis, myocardial infarction, repeat revascularization, rehospitalisation for angina) during follow-up (12 months), or time to last follow-up in case of no net adverse clinical event
Endpoint(s): Time-to-bleeding event defined according to BARC classification (BARC 2 to BARC 5) over 12 months follow up, taking into account the competing risk of death from non-haemorrhagic cause, or time to last follow-up in case of no bleeding event, Time-to-all cause death over 12 months follow-up, or time to last follow-up in case of no death, Major adverse ischemic clinical events (MACE): time-to-composite endpoint of ischemic stroke, cardiovascular death, stent thrombosis, repeat revascularization, rehospitalisation for angina over 12 months follow-up, taking into account the competing risk of death from non-cardiovascular cause, or time to last follow-up in case of no MACE, Compliance to drug regimen at 1-, 6- and 12-months follow-up, Total costs in each treatment group over the one-year study period, Total quality-adjusted life years in each treatment group over the one-year study period, Long-term cost-utility ratio (expressed in terms of additional costs per quality adjusted life year gained)

Source: https://euclinicaltrials.eu/ctis-public/view/2023-508148-23-01